EU clinical trial 2024-518151-29-00: MOVIE_A phase I/II basket trial evaluating a combination of Metronomic Oral Vinorelbine plus anti-PD-L1/anti-CTLA4 ImmunothErapy in patients with advanced solid tumours.
Protocol code: UC-0101/1709
Sponsor: Unicancer (Hospital/Clinic/Other health care facility). Phase: Phase I and Phase II (Integrated)- Bioequivalence Study. Countries: France (ended).
Therapeutic area(s): Diseases [C] - Neoplasms [C04]
Gender: Female, Male. Age: 0-17 years, 18-64 years, 65+ years. Enrolment: 126.
Status: Ended. Start date (EU): 2018-06-27. End date (EU): 2024-12-20. Decision date: 2024-10-29. Results received: No. Last updated: 2025-04-04.

Condition(s): Patients with locally advanced or metastatic solid tumours
Product: IMFINZI 50 mg/mL concentrate for solution for infusion.

Primary endpoint: Phase I: Determine MTD and the phase II recommended dose (RP2D) of metronomic oral vinorelbine associated with fixed dose of durvalumab + tremelimumab combination in patient with advanced solid tumour. All patients who receive any study treatment are monitored for toxicity and included in the safety analysis. To be evaluable for DLT, a patient must either be observed for full phase I duration period, i.e. 4-week DLT evaluation period from the treatment initiation,or have experienced DLT, Phase2:CBR defined as the rate of complete response (CR), partial response (PR), or SD lasting at least 24 weeks according to RECIST v1.1 and will be evaluated based on the best response status obtained until 24 weeks after starting treatment. Analysis of the primary endpoint will be carried out sequentially with interim analyses planned after 24 weeks of follow up of the first 10 patients of each cohort and then every 5 patients. At each analysis the Bayesian model will be updated
Endpoint(s): ORR, iORR, the iCBR24 will be presented with the associated 95% confidence intervals (CIs)., PFS, iPFS, OS, DoR, and iDoR will be estimated using the Kaplan-Meier method and will be described in terms of medians with the associated 95% CIs., The safety will be evaluated using the incidence of treatment emergent adverse events (TEAE), serious adverse Events (SAE), and deaths. Tolerance will be assessed by NCI-CTCAE v5.0 scale. Descriptive statistics will be provided for characterising and assessing patient tolerance to treatment.

Source: https://euclinicaltrials.eu/ctis-public/view/2024-518151-29-00